EU clinical trial 2023-509732-25-00: A dose-esalation phase I/II study in patients with RAS-mutated metastatic colorectal cancer to investigate safety and clinical actvitiy of the triple combination of: MEK-inhibitor binimetinib, pan-EGFR inhibitor lapatinib and the microtubule targeting agent (MTA) vinorelbine (RASTRIC)
Sponsor: Universitair Medisch Centrum Utrecht (Hospital/Clinic/Other health care facility). Phase: Phase I and Phase II (Integrated)- First administration to humans. Countries: Netherlands (ended).
Therapeutic area(s): Diseases [C] - Digestive System Diseases [C06]
Gender: Female, Male. Age: 18-64 years, 65+ years. Enrolment: 50.
Status: Ended. Start date (EU): 2020-07-31. End date (EU): 2025-02-17. Decision date: 2024-09-10. Results received: Yes. Last updated: 2024-09-10.

Condition(s): metastatic colorectal cancer with a proven RAS mutation after failure of standard systemic treatment regimens including at least 5- FU/capecitabine-oxaliplatin and irinotecan based standard treatment (unless contra-indications for either oxaliplatin or irinotecan)
Product: Mektovi 15 mg film-coated tablets, Tyverb 250 mg film-coated tablets, Vinorelbine Accord 10 mg/ml concentraat voor oplossing voor infusie

Primary endpoint: For the phase I dose-escalation trial, the primary endpoint is the incidence of DLTs leading to a RP2D. The RP2D of the triplet will be the MTD which is defined as the dose level that can be given to 6 subjects such that not more than 1 subject experiences a DLT, For the phase II trial the primary endpoint is objective response rate according to RECIST 1.1
Endpoint(s): the pharmacokinetic profile of the triple combination, safety and tolerability (frequencies of AEs, dose reductions) and additional anti-tumor efficacy parameters including clinical benefit rate and progression-free survival

Source: https://euclinicaltrials.eu/ctis-public/view/2023-509732-25-00